EU clinical trial 2023-503926-37-00: A Randomized, Double-blind, Placebo-controlled, Phase 2/3 Study to Assess the Efficacy, Safety, Tolerability, Pharmacokinetics, and Pharmacodynamics of Obeticholic Acid Compared to Placebo in Pediatric Subjects with Biliary Atresia, Post-hepatoportoenterostomy
Protocol code: 747-308
Sponsor: Intercept Pharmaceuticals Inc. (Pharmaceutical company). Phase: Phase II and Phase III (Integrated). Countries: Belgium (ended), Germany (ended), Netherlands (ended), France (not authorised), Italy (ended), Spain (ended), Poland (ended).
Therapeutic area(s): Diseases [C] - Digestive System Diseases [C06]
Gender: Female, Male. Age: 0-17 years, 18-64 years. Enrolment: 50.
Status: Ended. End date (EU): 2025-09-17. End date: 2025-10-21. Decision date: 2024-04-16. Results received: Yes. Last updated: 2025-10-03.
Decision dates by country: BE: 2024-04-16, FR: 2024-04-22, IT: 2024-04-19, ES: 2024-04-16, NL: 2024-04-16, PL: 2024-04-22, DE: 2024-04-17

Condition(s): Biliary Atresia, Post-hepatoportoenterostomy
Product: OCA IR 0.1 mg, 0,1 mg and 1,5 mg Placebo tablets, OCA 1.5 mg

Primary endpoint: Time to the first occurrence of any of the following clinical events., Time to first occurrence of: Death, Liver transplant, PELD score ≥17/MELD ≥15, Hospitalization (as defined by a stay of 24 hours or greater) for new onset or recurrence of: Variceal bleed; Hepatic encephalopathy (as defined by a West Haven score of ≥2); Spontaneous bacterial peritonitis (confirmed by diagnostic paracentesis), Clinically evident ascites related to poral hypertension (diuretic-resistant ascites requiring therapeutic paracentesis at a frequency of at least twice in a month)
Endpoint(s): PK exposure of OCA: Plasma unconjugated OCA (parent), glyco-OCA, tauro-OCA, and total OCA, Biomarkers of hepatobiliary function: GGT, total and direct (conjugated) bilirubin, Biomarkers of FXR activation (PD): Plasma FGF-19, C4, endogenous bile acids, Noninvasive assessment of liver stiffness (if available at site): Transient elastography, Disease progression: Plasma levels of fat-soluble vitamins (D and K), Safety and tolerability of OCA: Treatment-emergent adverse events (TEAEs) including serious adverse events (SAEs), electrocardiogram (ECG), physical exam, clinical laboratory results, and vital signs

Source: https://euclinicaltrials.eu/ctis-public/view/2023-503926-37-00